EU clinical trial 2023-504145-31-00: A phase II study of preoperative stereotactic radiation therapy boost combined with short-course immunotherapy (pembrolizumab versus placebo, randomized, double-blind) and standard chemotherapy in patients with newly diagnosed HER2-negative non-metastatic breast cancer with lack of early metabolic response in 18-fluorodeoxyglucoseFDG-PET/CT after 1st chemoterapy cycle
Protocol code: BREAST-BOOSTER
Sponsor: Narodowy Instytut Onkologii Im. Marii Sklodowskiej-Curie-Panstwowy Instytut Badawczy (Hospital/Clinic/Other health care facility). Phase: Therapeutic exploratory (Phase II). Countries: Poland (ongoing, recruiting).
Therapeutic area(s): Diseases [C] - Neoplasms [C04]
Gender: Female, Male. Age: 18-64 years, 65+ years. Enrolment: 78.
Status: Ongoing, recruiting. Start date (EU): 2024-06-10. Decision date: 2023-06-26. Results received: No. Last updated: 2024-02-21.

Condition(s): HER2 negative breast cancer
Product: Paclitaxelum Accord, 6 mg/ml, koncentrat do sporządzania roztworu do infuzji, Carbomedac, 10 mg/ml, koncentrat do sporządzania roztworu do infuzji, KEYTRUDA 25 mg/mL concentrate for solution for infusion, Natrium Chloratum 0,9% Baxter, roztwór do infuzji

Primary endpoint: Histopathological confirmation in the postoperative material of complete tumor regression after preoperative systemic treatment (pCR), defined as the absence of invasive tumor tissue in the breast and regional lymph nodes (AJCC/UICC definition, allows residual DCIS tissue as pCR ypT0/is N0)
Endpoint(s): Assessment of complete regression in the postoperative histopathological examination in the population of all 78 patients receiving preoperative chemotherapy and radiotherapy. The presence of pCR in more than 13 patients out of a group of 78 enrolled and receiving chemotherapy and radiotherapy will be treated as fulfillment of the secondary endpoint criterion, Evaluation of response to preoperative treatment by evaluating postoperative material in histopathological examination according to the RCB (Residual Cancer Burden) protocol, comparing the group treated with pembrolizumab with radiotherapy to the group treated with placebo and radiotherapy, by comparing the numerical RCB ratio between both groups, Assessment of time to recurrence of invasive cancer - (Invasive Disease Free Survival, IDFS), comparison of the group treated with pembrolizumab with radiotherapy to the group treated with placebo + radiotherapy (according to Proposal for Standardized Definitions for Efficacy End Points in Adjuvant Breast Cancer Trials: The STEEP System, Hudis et al. Journal of Clinical Oncology 2007), Comparison of quality of life - general health status based on the QL2 scale of the EORTC QLQ-C30 questionnaire of the group treated with pembrolizumab with radiotherapy to the group treated with placebo and radiotherapy

Source: https://euclinicaltrials.eu/ctis-public/view/2023-504145-31-00